EU clinical trial 2024-517360-37-00: A study investigating the effect of different approved medications on how the body processes the study compound RO7795081. RO7795081 is a new compound that may potentially be used in the treatment of type 2 diabetes and weight control.
Protocol code: BP45670
Sponsor: F. Hoffmann-La Roche AG (Pharmaceutical company). Phase: Human Pharmacology (Phase I)- Other. Countries: Netherlands (ended).
Therapeutic area(s): Diseases [C] - Nutritional and Metabolic Diseases [C18]
Gender: Female, Male. Age: 18-64 years, 65+ years. Enrolment: 50.
Status: Ended. Start date (EU): 2024-11-22. End date (EU): 2025-05-28. Decision date: 2024-11-08. Results received: No. Last updated: 2025-04-18.

Condition(s): Type 2 Diabetes and obesity

Source: https://euclinicaltrials.eu/ctis-public/view/2024-517360-37-00